EU clinical trial 2022-502623-22-00: A study to learn how safe the study treatment actinium-225-macropa-pelgifatamab (BAY3546828) is, how it affects the body, how it moves into, through and out of the body, and about its anticancer activity in men with advanced metastatic castration-resistant prostate cancer (mCRPC)
Protocol code: 22143
Sponsor: Bayer AG (Pharmaceutical company). Phase: Human Pharmacology (Phase I)- First administration to humans. Countries: Finland (ongoing, recruitment ended), Netherlands (ongoing, recruitment ended), Italy (authorised, recruitment pending), Sweden (authorised, recruitment pending).
Therapeutic area(s): Diseases [C] - Neoplasms [C04]
Gender: Male. Age: 18-64 years, 65+ years. Enrolment: 90.
Start date (EU): 2023-09-18. Decision date: 2023-07-12. Results received: No. Last updated: 2026-05-29.
Decision dates by country: IT: 2025-05-27, SE: 2025-05-14, FI: 2023-07-12, NL: 2023-11-10

Condition(s): Metastatic castration-resistant prostate cancer

Source: https://euclinicaltrials.eu/ctis-public/view/2022-502623-22-00